EU clinical trial 2024-513873-36-00: Exploration of the pathophysiology of cluster headache (AVF) in PET-MRI using [18F]F13640 F13640-AVF
Sponsor: Hospices Civils De Lyon (Hospital/Clinic/Other health care facility). Phase: Therapeutic exploratory (Phase II). Countries: France (ongoing, recruiting).
Therapeutic area(s): Diseases [C] - Nervous System Diseases [C10]
Gender: Male. Age: 18-64 years. Enrolment: 12.
Status: Ongoing, recruiting. Start date (EU): 2022-02-28. Decision date: 2024-09-12. Results received: No. Last updated: 2026-06-29.

Condition(s): Nervous System Diseases

Primary endpoint: Comparison of the different density maps of the functional receptors in the 2 periods Comparison of different regional cerebral blood flow maps in the 2 periods Correlations of BOLD fluctuations between distant regions: functional connectivity of patients in the 2 periods
Endpoint(s): Comparison of the different density maps of functional 5-HT1A receptors during the 2 periods before the crisis, during the crisis and post-attack. Comparison of different regional cerebral blood flow maps during the 2 periods before the attack, during the attack and post-attack. Correlations of BOLD fluctuations between distant regions: functional connectivity of patients during the 2 periods before the attack, during the attack and post-attack. Variation of the BOLD signal in active period duri

Source: https://euclinicaltrials.eu/ctis-public/view/2024-513873-36-00